EU clinical trial 2025-521169-28-00: A study to assess the safety and immunogenicity of a therapeutic hepatitis B virus vaccine, in healthy adults (RUBY).
Protocol code: AVX37-102
Sponsor: AstriVax (Pharmaceutical company). Phase: Human Pharmacology (Phase I)- First administration to humans. Countries: Belgium (ongoing, recruitment ended).
Therapeutic area(s): Diseases [C] - Virus Diseases [C02]
Gender: Female, Male. Age: 18-64 years. Enrolment: 16.
Status: Ongoing, recruitment ended. Start date (EU): 2025-05-06. Decision date: 2025-04-28. Results received: No. Last updated: 2025-04-28.

Condition(s): Hepatitis B

Source: https://euclinicaltrials.eu/ctis-public/view/2025-521169-28-00